EU clinical trial 2025-523239-21-00: Open Label Extension (OLE), multiple dose study to evaluate pharmacokinetics, safety, tolerability and efficacy of filgotinib in children and adolescents from 8 years to less than 18 years of age with juvenile idiopathic arthritis (JIA).
Protocol code: GLPG0634-CL-333
Sponsor: Alfasigma S.p.A. (Pharmaceutical company). Phase: Therapeutic confirmatory (Phase III). Countries: France (authorised, recruitment pending), Germany (ongoing, recruiting).
Therapeutic area(s): Diseases [C] - Immune System Diseases [C20]
Gender: Female, Male. Age: 0-17 years. Enrolment: 18.
Start date (EU): 2026-04-13. Decision date: 2026-04-01. Results received: No. Last updated: 2026-06-22.
Decision dates by country: DE: 2026-04-01, FR: 2026-04-01

Condition(s): Juvenile idiopathic arthritis
Product: Jyseleca 200 mg film-coated tablets, Jyseleca 100 mg film-coated tablets, GLPG0634

Primary endpoint: Frequency and severity of treatment-emergent adverse events (TEAEs), treatment-emergent serious adverse events (SAEs), and TEAEs leading to treatment discontinuation at each visit throughout the duration of the study.
Endpoint(s): Percentage of subjects with JIA (ACR) 30 response over time., Percentage of subjects with JIA ACR inactive disease., Percentage of subjects with JIA ACR clinical remission over time., Incidence of treatment-emergent uveitis (including severity)., Duration of response.

Source: https://euclinicaltrials.eu/ctis-public/view/2025-523239-21-00